EU clinical trial 2025-521073-13-00: Phase 1 study on SAR443122 bioavailability and food effect in healthy adults
Protocol code: BDR17182
Sponsor: Sanofi-Aventis Recherche & Developpement (Pharmaceutical company). Phase: Human Pharmacology (Phase I)- Bioequivalence Study. Countries: Netherlands (ended).
Therapeutic area(s): Diseases [C] - Immune System Diseases [C20]
Gender: Female, Male. Age: 18-64 years. Enrolment: 15.
Status: Ended. Start date (EU): 2025-06-11. End date (EU): 2025-07-25. Decision date: 2025-06-06. Results received: No. Last updated: 2025-07-21.

Condition(s): Colitis ulcerative

Source: https://euclinicaltrials.eu/ctis-public/view/2025-521073-13-00